EU clinical trial 2025-523597-17-00: A randomized, double-blind, placebo-controlled study to assess the effects of high concentration capsaicin patch (Qutenza) on neuropathic symptoms, nerve fibers, and microcirculation in painful diabetic peripheral neuropathy
Protocol code: Q-HEAL-001
Sponsor: Deutsche Diabetes Forschungsgesellschaft e.V. (Laboratory/Research/Testing facility). Phase: Therapeutic exploratory (Phase II). Countries: Germany (ongoing, recruiting).
Therapeutic area(s): Diseases [C] - Nervous System Diseases [C10]
Gender: Female, Male. Age: 18-64 years, 65+ years. Enrolment: 40.
Status: Ongoing, recruiting. Start date (EU): 2026-07-29. Decision date: 2026-01-20. Results received: No. Last updated: 2026-01-20.

Condition(s): Painful diabetic peripheral neuropathy
Product: Capsaicin 0.04% cutaneous patch, Qutenza 179 mg cutaneous patch

Primary endpoint: Change from Baseline in IENFD (PGP9.5) at site with repeated treatment at Week 35 compared to placebo (primary endpoint)
Endpoint(s): Change from Baseline in IENFD (GAP-43), IENFL and DNFL (PGP9.5, GAP-43) at site with repeated treatment at Week 35 compared to placebo, Change from Baseline in NPRS, PDQ7, NPSI, TSS, NSS, and MOS-12 at Week 11, Week 25, and Week 35 compared to placebo, Change from Baseline in LDF and tissue oxygenation at standard and treated sites at Week 11 and Week 35 compared to placebo, Change from Baseline in QST and monofilament at standard and treated sites at Week 11 and Week 35 compared to placebo, Change from Baseline in IENFD, IENFL and DNFL (PGP9.5, GAP-43) at Week 11 and Week 35 (at site with single treatment only) compared to placebo, Change from Baseline and from Week 10 in skin biopsy CD31 area and CD31-PGP9.5 at sites with single and repeated treatment at Week 35 compared to placebo, Proportion of participants with an improvement in NPRS, PDQ7, NPSI, TSS, and NSS items reflecting the intensity of general pain, burning pain, pressing pain, paroxysmal pain, evoked pain, dysesthesia, and paresthesia, if present at baseline, compared to placebo at end of study, Number and severity of treatment-emergent AEs and the frequency of AEs leading to discontinuation, number of SAEs compared to placebo, Proportion of participants who need rescue medication, frequency and amount of rescue medication, and time to first intake of rescue medication since randomization compared to placebo

Source: https://euclinicaltrials.eu/ctis-public/view/2025-523597-17-00